EU clinical trial 2023-507418-28-00: Tumor-Agnostic Precision Immuno-Oncology and Somatic Targeting Rational for You (TAPISTRY) Phase II Platform Trial
Protocol code: BO41932
Sponsor: F. Hoffmann-La Roche AG (Pharmaceutical company). Phase: Therapeutic exploratory (Phase II). Countries: France (ongoing, recruitment ended), Belgium (ongoing, recruitment ended), Poland (ongoing, recruitment ended), Germany (ongoing, recruitment ended), Portugal (ongoing, recruitment ended), Denmark (ongoing, recruitment ended), Spain (ongoing, recruitment ended), Italy (ongoing, recruitment ended).
Therapeutic area(s): Diseases [C] - Neoplasms [C04]
Gender: Female, Male. Age: 0-17 years, 18-64 years, 65+ years. Enrolment: 407.
Status: Ongoing, recruitment ended. Start date (EU): 2021-03-15. Decision date: 2024-07-12. Results received: No. Last updated: 2026-07-23.
Decision dates by country: BE: 2024-07-16, PL: 2024-08-04, DE: 2024-07-12, ES: 2024-09-11, PT: 2024-07-12, FR: 2024-08-05, IT: 2024-07-29, DK: 2024-07-16

Condition(s): Solid tumors
Product: Rozlytrek 200 mg hard capsules, Ipatasertib, INAVOLISIB, RO7223619, Tecentriq 1 200 mg concentrate for solution for infusion, Camonsertib, RO 743-5846/F07, INAVOLISIB, Rozlytrek, RO 743-5846/F04, Rozlytrek 100 mg hard capsules, INAVOLISIB, Alecensa 150 mg hard capsules, RO 749-9790/F02-02, Ipatasertib, INAVOLISIB

Primary endpoint: 1 Independent Review Committee (IRC)-assessed objective response rate (ORR) based on confirmed (≥4 weeks after initial documentation of response) objective response (per RECIST v1.1)
Endpoint(s): 1 IRC-assessed duration of response (DOR), clinical benefit rate (CBR), and progression-free survival (PFS) per RECIST v1.1, 2 Investigator (INV)-assessed ORR, DOR, CBR, and PFS per RECIST v1.1, 3 IRC- and INV-assessed time to CNS progression per RECIST v1.1, 4 Overall survival (OS), 5 Cohorts A, B, C, D, I, J, and K: IRC-assessed CNS-ORR, CNS-DOR, CNS-CBR, and CNS-PFS per RANO, 6 Cohorts A, B, C, D, I, J, and K: INV-assessed CNS-ORR, CNS-DOR, CNS-CBR, and CNS-PFS per RANO, 7 Cohorts A, B, C, D, E, H, I, J, K, L, M, and N: IRC-assessed ORR, DOR, CBR, and PFS per International Neuroblastoma Response Criteria (INRC), 8 Cohorts A, B, C, D, E, H, I, J, K, L, M, and N: INV-assessed ORR, DOR, CBR, and PFS per INRC, 9 Cohorts A, B, C, D, I, J, and K: IRC-assessed IC-ORR, IC-DOR, IC-CBR, IC-PFS rate per RECIST v1.1, 10. Cohorts A, B, C, D, I, J, and K: INV-assessed IC-ORR, IC-DOR, IC-CBR, IC-PFS per RECIST v1.1, 11. Descriptive endpoint of time to confirmed deterioration, change from baseline, proportion of patients with a clinical meaningful change on the Global Health Status, Physical Functioning, and Role Functioning scores from the European Organisation for Research and Treatment of Cancer (EORTC) QLQ-C30, 12. Descriptive endpoint of time to confirmed symptom onset or worsening from tumor-related symptom scores from the EORTC QLQ-C30 and EORTC IL71, 13. Incidence, type, and severity of adverse events (based on the NCI CTCAE v5.0), including serious adverse events, 14. Cohort K: for pediatric patients - evaluate the acceptability and palatability of pralsetinib with Acceptability Survey scores on Day 1 of Cycle 1

Source: https://euclinicaltrials.eu/ctis-public/view/2023-507418-28-00